EU clinical trial 2024-517339-30-00: A Phase 1/2, First-in-Human Study to Assess the Safety, Tolerability, Pharmacokinetics, Pharmacodynamics, and Anti_Tumor Activity of AVZO-021 as a Single Agent and in Combination Therapy in Patients with Advanced Solid Tumors.
Protocol code: AVZO-021-1001
Sponsor: Avenzo Therapeutics Inc. (Laboratory/Research/Testing facility). Phase: Phase I and Phase II (Integrated)- First administration to humans. Countries: Belgium (authorised, recruitment pending), Spain (authorised, recruitment pending), Italy (authorised, recruitment pending), Germany (authorised, recruitment pending), France (authorised, recruitment pending).
Therapeutic area(s): Diseases [C] - Neoplasms [C04]
Gender: Female, Male. Age: 18-64 years, 65+ years. Enrolment: 52.
Status: Authorised, recruitment pending. Decision date: 2025-03-03. Results received: No. Last updated: 2026-05-07.
Decision dates by country: BE: 2025-03-10, FR: 2025-03-05, DE: 2025-03-06, IT: 2025-03-05, ES: 2025-03-03

Condition(s): Advanced Solid Tumors

Source: https://euclinicaltrials.eu/ctis-public/view/2024-517339-30-00